EU clinical trial 2024-515286-34-00: Phase 1 Safety and Tolerability Study of ALN-F1202 in Healthy Adults.
Protocol code: ALN-F1202-HV-2412
Sponsor: Regeneron Pharmaceuticals Inc. (Pharmaceutical company). Phase: Human Pharmacology (Phase I)- First administration to humans. Countries: Belgium (ended).
Therapeutic area(s): Diseases [C] - Hemic and Lymphatic Diseases [C15]; Diseases [C] - Cardiovascular Diseases [C14]
Gender: Female, Male. Age: 18-64 years. Enrolment: 56.
Status: Ended. Start date (EU): 2025-03-06. End date (EU): 2026-07-30. Decision date: 2025-01-31. Results received: No. Last updated: 2026-06-02.

Condition(s): Healthy Volunteer

Source: https://euclinicaltrials.eu/ctis-public/view/2024-515286-34-00